EU clinical trial 2024-511073-29-00: A study to test the safety and tolerability of Lu AH69593 in adults that are healthy or have narcolepsy.
Protocol code: 20653A
Sponsor: H. Lundbeck A/S (Pharmaceutical company). Phase: Human Pharmacology (Phase I)- Other. Countries: Finland (ongoing, recruiting).
Therapeutic area(s): Diseases [C] - Nervous System Diseases [C10]
Gender: Female, Male. Age: 18-64 years. Enrolment: 104.
Status: Ongoing, recruiting. Start date (EU): 2025-06-13. Decision date: 2025-05-27. Results received: No. Last updated: 2026-05-19.

Condition(s): Narcolepsy

Source: https://euclinicaltrials.eu/ctis-public/view/2024-511073-29-00